EU clinical trial 2025-521690-14-00: Antidepressant effects of psilocybin in the absence of serotoninergic psychedelic experience: a dimensional functional neuroimaging approach
Protocol code: IRSP-PSI-2024-171
Sponsor: Fundacio Institut De Recerca De L'Hospital De La Santa Creu I Sant Pau (Hospital/Clinic/Other health care facility). Phase: Therapeutic exploratory (Phase II). Countries: Spain (authorised, recruitment pending).
Therapeutic area(s): Psychiatry and Psychology [F] - Mental Disorders [F03]
Gender: Female, Male. Age: 18-64 years, 65+ years. Enrolment: 60.
Status: Authorised, recruitment pending. Decision date: 2026-05-04. Results received: No. Last updated: 2026-07-31.

Condition(s): Major depressive disorder
Product: Pimavanserina 34 mg placebo cápsulas, Pimavanserin tartrate

Primary endpoint: Brain connectivity assessments using MRI: A resting-state functional sequence. A T1-weighted anatomical sequence. Using a brain rsNFC study model, beta measurement values will be obtained from the images. Statistically significant changes in these beta measures will be considered relevant to the study results.

Source: https://euclinicaltrials.eu/ctis-public/view/2025-521690-14-00